EU clinical trial 2025-524376-36-00: Bioequivalence study comparing two temazepam 20 mg tablet formulations after fasted administration; an open, randomized, single centre, single dose study with crossover design in healthy subjects
Protocol code: 3137001
Sponsor: Orion Corporation (Pharmaceutical company). Phase: Human Pharmacology (Phase I)- Bioequivalence Study. Countries: Czechia (ongoing, recruitment ended).
Therapeutic area(s): Diseases [C] - Nervous System Diseases [C10]
Gender: Female, Male. Age: 18-64 years. Enrolment: 24.
Status: Ongoing, recruitment ended. Start date (EU): 2026-07-22. Decision date: 2026-05-05. Results received: No. Last updated: 2026-05-25.

Condition(s): short-term treatment of insomnia

Source: https://euclinicaltrials.eu/ctis-public/view/2025-524376-36-00